EU clinical trial 2024-517019-57-00: A placebo-controlled trial with citalopram for the treatment of typical reflux symptoms in patients with reflux hypersensitivity or functional heartburn with incomplete proton pump inhibitor response.
Sponsor: UZ Leuven (Hospital/Clinic/Other health care facility). Phase: Therapeutic use (Phase IV). Countries: Belgium (ongoing, recruiting).
Therapeutic area(s): Diseases [C] - Digestive System Diseases [C06]
Gender: Female, Male. Age: 18-64 years. Enrolment: 100.
Status: Ongoing, recruiting. Start date (EU): 2018-04-10. Decision date: 2024-10-23. Results received: No. Last updated: 2024-10-23.

Condition(s): gastro-esophageal reflux disease
Product: Placebo tablet manufactured by Laboratoria Wolfs, Zwijndrecht. Ingredients (1 tablet, 488mg): Lactose monohydrate 320mg; Carmellose sodium 10mg; Corn starch 70mg; Cellulose microcrystalline 55mg; Silicium dioxide anhydrous 20mg Magnesium stearate 13mg, Citalopram Viatris 20 mg filmomhulde tabletten

Primary endpoint: Change in number of reflux episodes
Endpoint(s): Change in volume exposure of reflux, Change in number of reflux episodes with a high proximal extent, Change in esophageal sensitivity, Change in symptom severity, Predictive value of reflux assessment, assessment of esophageal sensitivity and reflux questionnaire

Source: https://euclinicaltrials.eu/ctis-public/view/2024-517019-57-00